EU clinical trial 2023-508264-29-00: A Phase 3b, Randomized, Double-blind Study of Nivolumab Combined with Ipilimumab versus Nivolumab Monotherapy for Patients with Previously Untreated Advanced Renal Cell Carcinoma and Intermediate- or Poor-Risk Factors
Protocol code: CA209-8Y8
Sponsor: Bristol-Myers Squibb Services Unlimited Company (Pharmaceutical company). Phase: Therapeutic confirmatory (Phase III). Countries: Spain (ongoing, recruitment ended), France (ongoing, recruitment ended), Austria (ongoing, recruitment ended), Romania (ongoing, recruitment ended), Poland (ongoing, recruitment ended), Italy (ongoing, recruitment ended), Greece (ongoing, recruitment ended), Czechia (ongoing, recruitment ended).
Therapeutic area(s): Diseases [C] - Neoplasms [C04]
Gender: Female, Male. Age: 18-64 years, 65+ years. Enrolment: 254.
Status: Ongoing, recruitment ended. Start date (EU): 2019-06-11. Decision date: 2024-01-30. Results received: No. Last updated: 2026-07-21.
Decision dates by country: AT: 2024-03-14, CZ: 2024-02-01, GR: 2024-03-19, IT: 2024-02-19, RO: 2024-02-05, ES: 2024-01-30, FR: 2024-02-02, PL: 2024-02-02

Condition(s): Advanced Renal Cell Carcinoma with Intermediate- or Poor-Risk Factors
Product: Ipilimumab, OPDIVO 10 mg/mL concentrate for solution for infusion., Sodium chloride 0.9%, solution for infusion, 5% Dextrose, solution for infusion

Primary endpoint: Progression free survival (PFS) by BICR, Overall Response Rate (ORR) by BICR
Endpoint(s): Overall survival (OS), Overall response rate (ORR) by Investigator, Disease control rate (DCR) by Investigator and by blinded independent central review (BICR), Duration of response (DoR) by Investigator and by blinded independent central review (BICR), Time to objective response (TTR) by Investigator and by blinded independent central review (BICR), Progression free survival (PFS) and PFS2 per Investigator, Incidence of adverse events (AEs), Serious Adverse Events, drug - related SAEs and significant changes in laboratory tests (Hematology tests, Coagulation tests), Clinical Chemistry Tests and Serology Tests), PFS, ORR and OS based on GEP signatures, Overall Survival based on programmed cell death protein ligand-1 (PD-L1) expression, Overall response rate (ORR) by BICR based on PD-L1 expression, Progression Free Survival (PFS) by BICR based on PD-L1 expression)

Source: https://euclinicaltrials.eu/ctis-public/view/2023-508264-29-00